EU clinical trial 2023-510026-32-00: A randomized, double-blind, placebo-controlled phase III study to evaluate the efficacy, safety, and tolerability of remibrutinib in patients with generalized myasthenia gravis, followed by an open-label extension phase.
Protocol code: CLOU064O12301
Sponsor: Novartis Pharma AG (Pharmaceutical company). Phase: Therapeutic confirmatory (Phase III). Countries: Spain (ongoing, recruiting), Belgium (ended), Netherlands (authorised, recruitment pending), Poland (ongoing, recruiting), Romania (ongoing, recruiting), France (ongoing, recruiting), Germany (ongoing, recruiting), Italy (ongoing, recruiting).
Therapeutic area(s): Diseases [C] - Nervous System Diseases [C10]
Gender: Female, Male. Age: 18-64 years, 65+ years. Enrolment: 131.
Start date (EU): 2025-06-11. Decision date: 2025-05-07. Results received: No. Last updated: 2026-06-26.
Decision dates by country: FR: 2025-05-09, NL: 2025-05-07, RO: 2025-05-07, BE: 2025-05-07, DE: 2025-10-15, PL: 2025-05-09, ES: 2025-05-08, IT: 2025-09-12

Condition(s): Generalized Myasthenia Gravis
Product: Placebo to Remibrutinib (LOU064) 00 mg film-coated tablet, LOU064

Primary endpoint: Change from baseline to Month 6 in Myasthenia Gravis Activity of Daily Living (MG-ADL) total score
Endpoint(s): Change from baseline to Month 6 in Quantitative MG (QMG) total score, Proportion of participants with ≥ 5 points reduction from baseline to Month 6 of QMG total score without rescue medication and/or strongly confounding prohibited medication, Proportion of participants with ≥ 3 points reduction from baseline to Month 6 of MG-ADL total score without rescue medication and/or strongly confounding prohibited medication, Proportion of participants achieving MSE at Month 6, defined as MG-ADL score of 0 or 1 at Month 6 without rescue therapy and/or strongly confounding prohibited medication, Change from baseline to Month 6 in MGC total score, Change from baseline to Month 6 in revised MG Quality of Life Questionnaire (MG-QOL15r) survey score, Incidence of adverse events and changes in clinical laboratory values, vital signs, and electrocardiograms, Columbia Suicide Severity Rating, Proportion of time during which participants showed a reduction from baseline of ≥ 2 points in MG-ADL score that was maintained up to Month 6, Proportion of early MG-ADL responders during treatment (early responders with first MG-ADL improvement from baseline of ≥ 2 points occurring by week 4）, Change from baseline to Month 6 in EuroQol-5 Dimensions-5 Level (EQ-5D-5L), Proportion of participants achieving a reduction of ≥ 3 points from baseline to Month 6 in MGC total score.

Source: https://euclinicaltrials.eu/ctis-public/view/2023-510026-32-00